EU clinical trial 2023-506268-15-00: ENLIGHTEN 2: A Phase III, Randomized, Blinded, Controlled, Parallel-Group Trial to Evaluate the Efficacy and Safety of LYR-210 for the Treatment of Chronic Rhinosinusitis (CRS) in Adults
Protocol code: LYR-210-2021-005
Sponsor: Lyra Therapeutics Inc. (Pharmaceutical company). Phase: Therapeutic confirmatory (Phase III). Countries: Hungary (ended), Belgium (ended), Germany (ended), Bulgaria (ended), Poland (ended).
Therapeutic area(s): Diseases [C] - Bacterial Infections and Mycoses [C01]
Gender: Female, Male. Age: 18-64 years, 65+ years. Enrolment: 94.
Status: Ended. Start date (EU): 2023-06-05. End date (EU): 2025-03-24. Decision date: 2023-10-05. Results received: Yes. Last updated: 2025-03-10.
Decision dates by country: HU: 2023-10-05, BE: 2023-10-16, PL: 2024-04-15, BG: 2023-11-09, DE: 2023-10-26

Condition(s): Chronic Rhinosinusitis (CRS) in Adults
Product: DEXAMETHASONE, LYR-210 System

Primary endpoint: The primary endpoint is the change from baseline (CFBL) in the 7-day average composite score of the 3 cardinal symptoms (3CS) of nasal blockage/obstruction/congestion, facial pain/pressure, and anterior/posterior nasal discharge at Week 24 in participant without nasal polyps.
Endpoint(s): 1.CFBL in the 7-day average composite score of 3CS at Week 24, 2.CFBL in the 7-day average CS score of nasal blockage/obstruction/congestion at Week 24, 3.CFBL in the 7-day average CS score of anterior/posterior nasal discharge at Week 24, 4.CFBL in the 7-day average CS score of facial pain/pressure at Week 24, 5.CFBL in the 22-item Sino-Nasal Outcome Test (SNOT-22) total score at Week 24, 6.Rescue treatment through Week 24, 7. CFBL in the percent opacification of the bilateral anterior and posterior ethmoids at Week 20, as determined by 3-D volumetric CT analysis.

Source: https://euclinicaltrials.eu/ctis-public/view/2023-506268-15-00